EU clinical trial 2023-506993-11-00: Study to evaluate the safety, tolerability, maximum tolerated dose and clinical activity of TNB-383B when given to patients with multiple myeloma
Protocol code: TNB383B.0001/M22-466
Sponsor: AbbVie Deutschland GmbH & Co. KG (Pharmaceutical company). Phase: Human Pharmacology (Phase I)- First administration to humans. Countries: Germany (ongoing, recruitment ended).
Therapeutic area(s): Diseases [C] - Neoplasms [C04]
Gender: Female, Male. Age: 18-64 years, 65+ years. Enrolment: 22.
Status: Ongoing, recruitment ended. Start date (EU): 2021-09-13. Decision date: 2023-11-23. Results received: No. Last updated: 2026-03-06.

Condition(s): Relapsed or refractory multiple myeloma

Source: https://euclinicaltrials.eu/ctis-public/view/2023-506993-11-00